EU clinical trial 2024-517678-12-00: Phase 1b/2 study of liposomal annamycin (l-annamycin) in patients with previously treated metastatic soft-tissue sarcomas (ANNA-SARC)
Protocol code: ANNA-SARC
Sponsor: Narodowy Instytut Onkologii Im. Marii Sklodowskiej-Curie Panstwowy Instytut Badawczy (Hospital/Clinic/Other health care facility). Phase: Phase I and Phase II (Integrated)- Other. Countries: Poland (ended).
Therapeutic area(s): Diseases [C] - Skin and Connective Tissue Diseases [C17]; Diseases [C] - Neoplasms [C04]
Gender: Female, Male. Age: 18-64 years, 65+ years. Enrolment: 30.
Status: Ended. Start date (EU): 2021-01-14. End date (EU): 2025-03-31. Decision date: 2025-01-11. Results received: Yes. Last updated: 2025-01-11.

Condition(s): METASTATIC SOFT-TISSUE SARCOMAS AFTER FAILURE ON AT LEAST ONE SYSTEMIC THERAPY
Product: Liposomal Annamycin

Primary endpoint: Phase Ib: to determine the Recommended Phase 2 Dose (RP2D), Phase II: to evaluate 3-month Progression-Free Survival (PFS).
Endpoint(s): Phase Ib/II: Overall response rate (ORR): complete response (CR) and partial response (PR) as per revised Response Evaluation Criteria in Solid Tumours (RECIST) guidelines (Version 1.1), Clinical benefit (disease control) rate: CR + PR + stable disease (SD), Overall survival (OS), the potential for surgical resectability after L-Annamycin administration, pathological complete response (pCR) if surgical resection occurs and duration of response per RECIST guidelines (Version 1.1).

Source: https://euclinicaltrials.eu/ctis-public/view/2024-517678-12-00